EU clinical trial 2024-520449-21-00: Cemiplimab maintenance treatment for advanced adrenocortical cancer
Sponsor: Azienda Socio Sanitaria Territoriale Degli Spedali Civili Di Brescia (Hospital/Clinic/Other health care facility). Phase: Therapeutic exploratory (Phase II). Countries: Italy (ongoing, recruiting).
Therapeutic area(s): Diseases [C] - Neoplasms [C04]
Gender: Female, Male. Age: 18-64 years, 65+ years. Enrolment: 31.
Status: Ongoing, recruiting. Start date (EU): 2025-09-18. Decision date: 2025-06-05. Results received: No. Last updated: 2025-06-05.

Condition(s): Adrenocortical carcinoma
Product: Lysodren 500 mg tablets, LIBTAYO 350 mg concentrate for solution for infusion.

Primary endpoint: To evaluate the effect of cemiplimab as a maintenance immunotherapy on PFS in patients with advanced ACC with no disease progression after 4–6 EDP-M cycles.
Endpoint(s): OS: time from the date of the study start to the date of death due to any cause., QoL: EORTC QLQ-C30 questionnaire., AEs and laboratory abnormalities as graded by NCI CTCAE v5.0.

Source: https://euclinicaltrials.eu/ctis-public/view/2024-520449-21-00